EU clinical trial 2024-516559-41-00: Magnet Study - A Multi-arm, Adaptive, Group-sequential trial NETwork to evaluate drug efficacy in patients with Amyotrophic Lateral Sclerosis (ALS)
Protocol code: Magnet Lithium
Sponsor: Stichting TRICALS Foundation (Laboratory/Research/Testing facility). Phase: Therapeutic confirmatory (Phase III). Countries: Sweden (ended), Netherlands (ended), Spain (ended), Belgium (ended).
Therapeutic area(s): Diseases [C] - Nervous System Diseases [C10]; Phenomena and Processes [G] - Musculoskeletal and Neural Physiological Phenomena [G11]
Gender: Female, Male. Age: 18-64 years, 65+ years. Enrolment: 75.
Status: Ended. End date (EU): 2025-10-31. End date: 2025-11-01. Decision date: 2024-11-08. Results received: No. Last updated: 2025-06-24.
Decision dates by country: BE: 2024-12-02, ES: 2024-11-11, SE: 2024-11-12, NL: 2024-11-08

Condition(s): ALS / Amyotrophic Lateral Sclerosis
Product: The placebo capsules will have a formulation with lactose and polyvinylpyrrolidone to compensate the api mass in the active product. all excipients are widely used in the manufacturing of oral solid formulations., LITHIUM

Primary endpoint: Overall survival, defined as time to death from any cause or respiratory insufficiency (DRI; defined as tracheostomy or the use of non-invasive ventilation for ≥22 h per day for ≥10 consecutive days).
Endpoint(s): Composite endpoint evaluating daily functioning and survival based on the joint model framework of survival and longitudinal ALSFRS-R total scores., Daily functioning, defined as mean change from baseline in ALSFRS-R total score., Respiratory function, defined as mean change from baseline in SVC (%predicted of normal according to the GLI-2012 reference standard)., Quality of life, defined as change from baseline on the Visual Analogue Scale (single-item scale) and EQ-5D., Neuropsychological status, defined as change from baseline on the ECAS and ALS-FTD-Q., Clinical disease stage, defined as mean time spent in each stage of the King’s and ALS Milano-Torino staging systems., Change from baseline in laboratory parameters: Urinary P75ECD, Neurofilament light and heavy chain, Plasma creatinine, Tolerability defined as time-to-discontinuation of assigned treatment since randomization., Safety based on the safety assessments including neurological examinations, clinical laboratory evaluations, vital signs and frequency of adverse events (AEs) or serious adverse events (SAEs). (S)AEs will be categorized according to the Medical Dictionary for Regulatory Activities (MedDRA) and will be rated for severity and association with study drug.

Source: https://euclinicaltrials.eu/ctis-public/view/2024-516559-41-00